EU clinical trial 2025-522168-34-00: BRECHE : Efficacy of sphenopalatine block compared to blood patch in the management of post-dural puncture syndrome.
Protocol code: RBHP 2025 GUYOT
Sponsor: University Hospital Of Clermont-Ferrand (Hospital/Clinic/Other health care facility). Phase: Therapeutic exploratory (Phase II). Countries: France (ongoing, recruiting).
Therapeutic area(s): Analytical, Diagnostic and Therapeutic Techniques and Equipment [E] - Therapeutics [E02]; Analytical, Diagnostic and Therapeutic Techniques and Equipment [E] - Anesthesia and Analgesia [E03]; Analytical, Diagnostic and Therapeutic Techniques and Equipment [E] - Investigative Techniques [E05]; Analytical,Diagnostic,Therapeutic Techniques and Equipment [E]-Surgical Procedures, Operative [E04]
Gender: Female, Male. Age: 18-64 years, 65+ years. Enrolment: 80.
Status: Ongoing, recruiting. Start date (EU): 2026-02-19. Decision date: 2025-11-12. Results received: No. Last updated: 2026-04-01.

Condition(s): Post-dural puncture syndrome
Product: XYLOCARD® 50mg/ml, solution injectable pour perfusion, EMLA® 5 POUR CENT, crème

Primary endpoint: Evolution of headache intensity in the upright position assessed using a numerical verbal scale (NVS) from 0 (no pain) to 10 (the most intense pain possible) at the beginning of the intervention, at 30 minutes, 1 hour, 2 hours, 6 hours, 24 hours, 48 hours, and 7 days after the performance of the sphenopalatine block or blood patch.
Endpoint(s): The consumption of analgesics (Acétaminophen, Nefopam, NSAIDs, morphine) in milligrams after the procedure and for 7 days., The need for a rescue treatment with a blood patch after the first procedure, The duration of hospitalization during the 7 days post-intervention, The intensity of headaches at 30 minutes, at 1 hour, at 2 hours, at 6 hours, at 24 hours, at 48 hours, and at 7 days., The undesirable events during the performance of the procedure, Serious adverse events (radicular compression, meningitis, cauda equina syndrome...),, Patient satisfaction assessed at 7 days after treatment using a 5-item Likert scale

Source: https://euclinicaltrials.eu/ctis-public/view/2025-522168-34-00